EU clinical trial 2025-521055-23-00: ARGX-113-2409: A Multicenter, Randomized, Double-blinded, Parallel-Arm, Placebo- Controlled, Pharmacokinetic and Pharmacodynamic Study Followed by an Open-Label Arm to Evaluate Efgartigimod IV in Pediatric Participants from 12 Years to Less Than 18 Years of Age with Chronic ITP
Protocol code: ARGX-113-2409
Sponsor: Argenx (Pharmaceutical company). Phase: Phase II and Phase III (Integrated). Countries: Lithuania (authorised, recruiting), Romania (ongoing, recruiting), Hungary (authorised, recruitment pending), France (authorised, recruiting), Italy (ongoing, recruiting), Spain (ongoing, recruiting), Poland (authorised, recruiting), Germany (authorised, recruiting).
Therapeutic area(s): Diseases [C] - Immune System Diseases [C20]
Gender: Female, Male. Age: 0-17 years. Enrolment: 19.
Start date (EU): 2025-10-07. Decision date: 2025-09-24. Results received: No. Last updated: 2026-07-09.
Decision dates by country: HU: 2025-09-29, RO: 2025-10-17, PL: 2025-11-03, LT: 2025-09-26, DE: 2026-02-05, IT: 2025-09-24, ES: 2025-10-21, FR: 2025-09-29

Condition(s): Chronic Idiopathic thrombocytopenic purpura
Product: ARGX-113, Placebo for efgartigimod

Primary endpoint: 1) Efgartigimod serum concentrations as input for compartmental, model-driven analysis to determine age and size dependency of clearance and volume of distribution of efgartigimod IV in the DBTP, 2) Total IgG levels as input for PK/PD modeling analysis in the DBTP
Endpoint(s): 1) Efgartigimod serum concentrations over time during the DBTP, 2) Percent change from baseline in total IgG levels in serum over time during the DBTP, 3) Incidence, severity, and relatedness of the IMP to AEs, SAEs, and AEs leading to IMP discontinuation, 4) Clinically significant changes in laboratory parameters, ECGs, and vital signs, 5) Sustained platelet count response, defined as achieving platelet counts of ≥50 × 109/L for at least 4 of the 6 study visits between study weeks 19 and 24 of the DBTP and in OLTP1 for participants receiving placebo in the DBTP, 6) Extent of disease control, defined as the number of cumulative weeks with a platelet count of ≥50 × 109/L during the DBTP and the first 24 weeks of OLTP1 for participants receiving placebo in the DBTP, 7) Actual values and changes from baseline for platelet counts over time, 8) Incidence and severity of bleeding, assessed by the Modified Buchanan and Adix Bleeding Score for pediatric ITP15, 9) Incidence and prevalence of ADA and NAb against efgartigimod in serum, 10) Change from baseline in: − EQ-5D-5L − KIT Child Self-Report and KIT Parent Impact Report − pedsFACIT-F, 11) Measurement of immature platelet fractions (IPF#and IPF%) in blood samples over time

Source: https://euclinicaltrials.eu/ctis-public/view/2025-521055-23-00